EU clinical trial 2024-516828-33-00: Bioequivalence of Lisdexamfetamine dimesylate 10 mg/mL Oral Solution in Healthy Participants Under Fasting Conditions.
Protocol code: BLCL-LIS-EU-03
Sponsor: Pharmaplot P.C. (Pharmaceutical company). Phase: Human Pharmacology (Phase I)- Bioequivalence Study. Countries: Portugal (ended).
Therapeutic area(s): Not possible to specify
Gender: Female, Male. Age: 18-64 years. Enrolment: 60.
Status: Ended. Start date (EU): 2024-11-15. End date (EU): 2024-12-23. Decision date: 2024-10-22. Results received: No. Last updated: 2024-10-22.

Condition(s): No medical condition.

Source: https://euclinicaltrials.eu/ctis-public/view/2024-516828-33-00